EU clinical trial 2023-509865-19-00: PHASE 3 RANDOMIZED STUDY OF DS-1062A VERSUS DOCETAXEL IN PREVIOUSLY TREATED ADVANCED OR METASTATIC NON-SMALL CELL LUNG CANCER WITH OR WITHOUT ACTIONABLE GENOMIC ALTERATIONS (TROPION-LUNG01)
Protocol code: DS1062-A-U301
Sponsor: Daiichi Sankyo Inc. (Pharmaceutical company). Phase: Therapeutic confirmatory (Phase III). Countries: Spain (ended), Poland (ended), France (ended), Belgium (ongoing, recruitment ended), Italy (ended), Netherlands (ended), Germany (ended).
Therapeutic area(s): Diseases [C] - Neoplasms [C04]
Gender: Female, Male. Age: 18-64 years, 65+ years. Enrolment: 261.
Start date (EU): 2021-04-30. Decision date: 2024-07-23. Results received: No. Last updated: 2025-12-15.
Decision dates by country: BE: 2024-07-23, IT: 2024-07-30, ES: 2024-07-23, NL: 2024-07-23, PL: 2024-07-29, DE: 2024-07-25, FR: 2024-08-19

Condition(s): Advanced or Metastatic Non-small Cell Lung Cancer (NSCLC)
Product: Datopotamab deruxtecan, DOCETAXEL

Primary endpoint: PFS is defined as the time from randomization to the earlier of the dates of the first radiographic disease progression or death due to any cause., OS is defined as the time from randomization to death due to any cause.
Endpoint(s): PFS is defined as the time from randomization to the earlier of the dates of the first radiographic disease progression or death due to any cause., ORR is defined as the proportion of subjects who achieved a BOR of CR or PR., DoR is defined as the time from the date of the first documentation of objective response (CR or PR) to the date of the first radiographic disease progression or death due to any cause, whichever occurs first., DCR is defined as the proportion of subjects who achieved a BOR of CR, PR, or SD., TTR is defined as the time from randomization to the date of the first documentation of objective response (CR or PR) in responding subjects.

Source: https://euclinicaltrials.eu/ctis-public/view/2023-509865-19-00